EU clinical trial 2022-502686-24-00: A Phase 3, Open-label, Randomized, Prospective Study of Apalutamide with Continued Versus Intermittent Androgen-Deprivation Therapy (ADT) following PSA Response in Participants with Metastatic Castration-Sensitive Prostate Cancer (mCSPC)
Protocol code: 56021927PCR3020
Sponsor: Janssen - Cilag International (Pharmaceutical company). Phase: Therapeutic confirmatory (Phase III). Countries: Germany (ongoing, recruitment ended), France (ongoing, recruitment ended), Poland (ongoing, recruitment ended).
Therapeutic area(s): Diseases [C] - Neoplasms [C04]
Gender: Male. Age: 18-64 years, 65+ years. Enrolment: 78.
Status: Ongoing, recruitment ended. Start date (EU): 2023-11-22. Decision date: 2023-09-25. Results received: No. Last updated: 2026-06-30.
Decision dates by country: PL: 2023-10-02, FR: 2023-09-25, DE: 2023-10-02

Condition(s): Metastatic Castration-Sensitive Prostate Cancer (mCSPC)
Product: JNJ-56021927

Primary endpoint: - 18-month radiographic progression-free survival rate. Radiographic progression will be assessed by investigators using conventional imaging - 18-month percent change in severity adjusted hot flash score

Source: https://euclinicaltrials.eu/ctis-public/view/2022-502686-24-00